EU clinical trial 2024-513486-39-00: Does Colchicine Reduce Progression of Aortic Valve Stenosis? Colchicine and Inflammation in Aortic Stenosis (CHIANTI): A placebo-controlled, double-blind, multicenter randomized trial.
Sponsor: Stichting Radboud universitair medisch centrum (Hospital/Clinic/Other health care facility). Phase: Therapeutic confirmatory (Phase III). Countries: Netherlands (authorised, recruitment pending).
Therapeutic area(s): Diseases [C] - Cardiovascular Diseases [C14]
Gender: Female, Male. Age: 18-64 years, 65+ years. Enrolment: 150.
Status: Authorised, recruitment pending. Decision date: 2024-12-06. Results received: No. Last updated: 2025-06-03.

Condition(s): Aortic Valve Calcification, Inflammation, Calcification, Aortic Valve Disease, Cardiovascular Diseases, Aortic Valve Stenosis
Product: Placebo Colchicine 0.5 mg tablets, Colchicine Tiofarma 0,5 mg, tabletten

Primary endpoint: The change in aortic valve calcium score measured by computed tomography (Agatston Units) at 24 months relative to baseline.
Endpoint(s): The change in 18F-NaF uptake of the aortic valve on positron emission tomography at 24 months relative to baseline., The change in peak aortic jet velocity (m/s) measured by echocardiography at 24 months relative to baseline.

Source: https://euclinicaltrials.eu/ctis-public/view/2024-513486-39-00